EU clinical trial 2023-509460-19-00: A phase 1b-2 study of mitomycin-C / capecitabine chemoradiotherapy combined with ipilumimab and nivolumab or nivolumab monotherapy as bladder sparing curative treatment for muscle invasive bladder cancer: the CRIMI study
Sponsor: Amsterdam UMC (Hospital/Clinic/Other health care facility). Phase: Phase I and Phase II (Integrated)- Other. Countries: Netherlands (ongoing, recruitment ended).
Therapeutic area(s): Diseases [C] - Neoplasms [C04]
Gender: Female, Male. Age: 18-64 years, 65+ years. Enrolment: 50.
Status: Ongoing, recruitment ended. Start date (EU): 2024-10-11. Decision date: 2024-10-11. Results received: No. Last updated: 2024-10-11.

Condition(s): Muscle Invasive bladder cancer
Product: OPDIVO 10 mg/mL concentrate for solution for infusion., YERVOY 5 mg/ml concentrate for solution for infusion, Capecitabine Teva 150 mg film-coated tablets., Mitomycine Accord 40 mg, poeder voor oplossing voor injectie/infusie

Primary endpoint: In the phase Ib study: toxicity scored with CTCAE v 4.03; incidence of dose limiting toxicity (DLT) during the first 6 weeks after start of the combination, In the phase II study: disease free survival (DFS) and disease free survival-rate (DFS-rate)
Endpoint(s): Overall Survival, Overall survival-rate, Response rate according to RECIST 1.1, Toxicity according to CTCAE v4.03

Source: https://euclinicaltrials.eu/ctis-public/view/2023-509460-19-00